EU clinical trial 2023-504600-28-00: A Phase 2/3, Randomized Study to Evaluate the Optimized dose, Safety, and Efficacy of Livmoniplimab in Combination with Budigalimab in Subjects with Locally Advanced or Metastatic Hepatocellular Carcinoma (HCC) who have not previously received systemic treatment
Protocol code: M24-052
Sponsor: AbbVie Deutschland GmbH & Co. KG (Pharmaceutical company). Phase: Phase II and Phase III (Integrated). Countries: Italy (ongoing, recruitment ended), France (ongoing, recruitment ended), Spain (ongoing, recruitment ended).
Therapeutic area(s): Diseases [C] - Immune System Diseases [C20]
Gender: Female, Male. Age: 18-64 years, 65+ years. Enrolment: 40.
Status: Ongoing, recruitment ended. Start date (EU): 2024-05-09. Decision date: 2024-04-24. Results received: No. Last updated: 2026-08-06.
Decision dates by country: FR: 2024-04-26, ES: 2024-04-26, IT: 2024-04-24

Condition(s): Metastatic Hepatocellular Carcinoma (HCC)
Product: TREMELIMUMAB, BEVACIZUMAB, Livmoniplimab, Budigalimab, ATEZOLIZUMAB, IMFINZI 50 mg/mL concentrate for solution for infusion.

Primary endpoint: The primary endpoint for Stage 1 is the BOR of CR/PR per RECIST 1.1 by investigator., The primary endpoint for Stage 2 is OS.
Endpoint(s): The secondary endpoints for Stage 1 are PFS, DoR per RECIST 1.1 by investigator, OS, safety and tolerability, and PK assessments., The secondary endpoints for Stage 2 are PFS, BOR of CR/PR, and DOR per RECIST 1.1 by BICR and by investigator, PFS, BOR of CR/PR and DoR per iRECIST by BICR and by investigator; and PROs.

Source: https://euclinicaltrials.eu/ctis-public/view/2023-504600-28-00